EU clinical trial 2025-524937-19-00: Methylphenidate for Early Awakening in Coma (MEAWAKE)
Protocol code: MEAWAKE_1
Sponsor: Rigshospitalet (Hospital/Clinic/Other health care facility). Phase: Therapeutic exploratory (Phase II). Countries: Austria (authorised, recruitment pending), Denmark (authorised, recruitment pending), Germany (authorised, recruitment pending), France (authorised, recruitment pending).
Therapeutic area(s): Diseases [C] - Nervous System Diseases [C10]
Gender: Female, Male. Age: 18-64 years, 65+ years. Enrolment: 324.
Status: Authorised, recruitment pending. Decision date: 2026-04-27. Results received: No. Last updated: 2026-05-04.
Decision dates by country: AT: 2026-04-30, DK: 2026-04-27, FR: 2026-04-27, DE: 2026-05-04

Condition(s): Coma due to acute brain injury
Product: METHYLPHENIDATE, Placebo manufactured by the hospital pharmacy of the Capital Region in Denmark; The placebo product does not contain active substance and is otherwise identical to the IMP after preparation.

Primary endpoint: Time to awakening, defined as first sustained improvement in consciousness (FOUR, e = 4; or FOUR, total score ≥12; or SECONDs ≥6; confirmed on two consecutive exams 1h apart).
Endpoint(s): Proportion of patients achieving clinical arousal, ICU mortality and length of stay, 3-month outcome (mRS, CPC, GOS-E)

Source: https://euclinicaltrials.eu/ctis-public/view/2025-524937-19-00